EU clinical trial 2022-500449-26-00: Pan-European proof-of-concept study comparing Decentralised Clinical Trial (DCT) and hybrid approaches to conventional clinical trial approaches in patients with Type 2 diabetes mellitus treated with Toujeo®
Protocol code: RADIAL
Sponsor: University Medical Center Utrecht (Hospital/Clinic/Other health care facility). Phase: Therapeutic use (Phase IV). Countries: Denmark (ended), Italy (ended), Spain (ended), Poland (ended), Germany (ended).
Therapeutic area(s): Diseases [C] - Nutritional and Metabolic Diseases [C18]
Gender: Female, Male. Age: 18-64 years, 65+ years. Enrolment: 500.
Status: Ended. Start date (EU): 2023-08-03. End date (EU): 2024-11-19. End date: 2024-11-20. Decision date: 2022-11-02. Results received: Yes. Last updated: 2024-08-12.
Decision dates by country: IT: 2022-11-23, ES: 2022-11-25, DK: 2022-11-02, PL: 2022-11-28, DE: 2022-11-17

Condition(s): Type 2 diabetes mellitus (T2DM)
Product: Toujeo 300 units/ml SoloStar, solution for injection in a pre-filled pen

Primary endpoint: Objective 1: Time to enrolment from Site activation until last participant enrolled; Proportion of participants completing the study period; Various diversity aspects such as race, ethnicity, socioeconomic status etc. Objective 2: Time from event occurrence to collection AE/SAE in the eDiary or eCRF. Adherence to the daily insulin injection by means of eDiary analysis in percentage of days of documented intake until participant's EOT
Endpoint(s): HbA1c change from baseline to Week 24; HbA1c change from baseline to Week 12; Fasting SMPG change from baseline to Week 24; Fasting SMPG change from baseline to Week 12; Percentage (%) of participants reaching HbA1c level <7% (53 mmol/mol) at Week 12 and Week 24; Percentage (%) of participants reaching fasting SMPG target of 80–130 mg/dL (4.4 -7.2 mmol/L) at Week 12 and 24; Percentage (%) of participants reaching target HbA1c <7% (53 mmol/mol) Week 12 and Week 24 without severe and/or confirmed

Source: https://euclinicaltrials.eu/ctis-public/view/2022-500449-26-00